EU clinical trial 2026-525748-14-00: A clinical trial of MK-1824 in healthy participants (MK-1824-001)
Protocol code: MK-1824-001
Sponsor: Merck Sharp & Dohme LLC (Pharmaceutical company). Phase: Human Pharmacology (Phase I)- First administration to humans. Countries: Belgium (ongoing, recruiting).
Therapeutic area(s): Diseases [C] - Cardiovascular Diseases [C14]
Gender: Male. Age: 18-64 years. Enrolment: 16.
Status: Ongoing, recruiting. Start date (EU): 2026-05-26. Decision date: 2026-05-12. Results received: No. Last updated: 2026-05-12.

Condition(s): Heart failure with preserved ejection fraction

Source: https://euclinicaltrials.eu/ctis-public/view/2026-525748-14-00